EU clinical trial 2024-515265-34-00: Virological and immunological assessment in HIV positive participants on 2DR versus 3DR in a prospective randomized controlled switch trial.
Protocol code: 2DR-study (Rumba)
Sponsor: Universitair Ziekenhuis Gent (Hospital/Clinic/Other health care facility). Phase: Therapeutic use (Phase IV). Countries: Belgium (ended).
Therapeutic area(s): Diseases [C] - Virus Diseases [C02]
Gender: Female, Male. Age: 18-64 years, 65+ years. Enrolment: 134.
Status: Ended. Start date (EU): 2020-05-26. End date (EU): 2026-03-12. Decision date: 2024-10-09. Results received: No. Last updated: 2024-10-09.

Condition(s): human immunodeficiency viruses (HIV)
Product: Biktarvy 50 mg/200 mg/25 mg film-coated tablets, Dovato 50 mg/300 mg film-coated tablets, Dovato 50 mg/300 mg film-coated tablets, Dovato 50 mg/300 mg film-coated tablets, Biktarvy 50 mg/200 mg/25 mg film-coated tablets, Dovato 50 mg/300 mg film-coated tablets, Biktarvy 50 mg/200 mg/25 mg film-coated tablets, Biktarvy 50 mg/200 mg/25 mg film-coated tablets

Primary endpoint: The primary endpoint is the amount of intact replication competent HIV sequences at W48 quantified by the fraction intact HIV viral sequences quantified by an intact proviral DNA assay, present in blood CD4 cells.
Endpoint(s): Quantification of viral markers as total and intact HIV DNA, and RNA transcripts at baseline, W48, W144 and W240., Full length sequencing of the virus at baseline, W144 and W240., Quantification of human pro-inflammatory mediators and markers of microbial translocation at baseline, W48, W144 and W240., Phenotype of innate immune cells at baseline W48, W144, W240., Function of immune cells at baseline,W144 and W240., Metabolic parameters at baseline, W24, W48, W72, W96, W120,W144, W186, W192, W216 and W240., Analysis of cardio-vascular risk at W240 based on risk stratification at D0, W48 and W144 in all or a subgroup of individuals.

Source: https://euclinicaltrials.eu/ctis-public/view/2024-515265-34-00